EU clinical trial 2025-521593-33-00: A research study of a new medicine NNC0363-1063 in participants with type 1 diabetes
Protocol code: NN1644-8194
Sponsor: Novo Nordisk A/S (Pharmaceutical company). Phase: Human Pharmacology (Phase I)- Other. Countries: Germany (ended).
Therapeutic area(s): Diseases [C] - Nutritional and Metabolic Diseases [C18]
Gender: Female, Male. Age: 18-64 years. Enrolment: 36.
Status: Ended. Start date (EU): 2025-12-03. End date (EU): 2026-05-08. Decision date: 2025-11-20. Results received: No. Last updated: 2026-07-23.

Condition(s): Diabetes type 1

Source: https://euclinicaltrials.eu/ctis-public/view/2025-521593-33-00